EU clinical trial 2024-513822-53-00: REPLACE - A multi-centre, randomised, double-blinded, placebo controlled 16-weeks study to compare the effect of hydrocortisone and placebo in patients with Giant Cell Arteritis (GCA)/ Polymyalgia Rheumatica (PMR) with patient-reported symptoms of adrenal insufficiency after cessation of glucocorticoid treatment.
Sponsor: Odense University Hospital (Hospital/Clinic/Other health care facility). Phase: Therapeutic use (Phase IV). Countries: Denmark (ended).
Therapeutic area(s): Diseases [C] - Hormonal diseases [C19]
Gender: Female, Male. Age: 18-64 years, 65+ years. Enrolment: 270.
Status: Ended. Start date (EU): 2022-02-01. End date (EU): 2026-01-12. Decision date: 2024-07-31. Results received: No. Last updated: 2024-07-31.

Condition(s): Tertiary adrenal insufficiency
Product: PLACEBO, Hydrokortison ”Orion”, tabletter

Primary endpoint: Adrenal insufficiency symptoms (AddiQoL-30)
Endpoint(s): Patient reported symptoms of fatigue, questionnaire-based HRQoL other than AddiQoL-30, incidence of adrenal crises, hospitalizations and sick days, Blood pressure and arterial stiffness, Body composition and muscle strength, Metabolic and cardiovascular risk, Bone status, Biological integrated cortisol status assessment

Source: https://euclinicaltrials.eu/ctis-public/view/2024-513822-53-00